EU clinical trial 2022-501171-14-00: Monocentric phase 1 dose-escalation study of siltuximab in combination with idarubicin and cytarabine chemotherapy in patients with poor prognosis acute myelogenous leukemia (AML): SILTUXILAM
Protocol code: RC22_0233
Sponsor: Centre Hospitalier Universitaire De Nantes (Hospital/Clinic/Other health care facility). Phase: Human Pharmacology (Phase I)- Other. Countries: France (ongoing, recruiting).
Therapeutic area(s): Diseases [C] - Hemic and Lymphatic Diseases [C15]
Gender: Female, Male. Age: 18-64 years, 65+ years. Enrolment: 12.
Status: Ongoing, recruiting. Start date (EU): 2023-03-13. Decision date: 2022-11-28. Results received: No. Last updated: 2025-04-02.

Condition(s): adult patients with acute myeloblastic leukemia (AML) of poor prognosis first Line or Relapse

Source: https://euclinicaltrials.eu/ctis-public/view/2022-501171-14-00